EU clinical trial 2023-508231-31-00: A Phase 2, Randomized, Double-blind, Placebo-controlled, Multi-center Study to Assess the Efficacy and Safety of Verekitug (UPB-101) in Participants with Chronic Rhinosinusitis with Nasal Polyps on a Background of Nasal Corticosteroids (VIBRANT)
Protocol code: UPB-CP-03
Sponsor: Upstream Bio Inc. (Pharmaceutical company). Phase: Therapeutic exploratory (Phase II). Countries: Germany (ended), Czechia (ended), Spain (ended), Poland (ended).
Therapeutic area(s): Diseases [C] - Respiratory Tract Diseases [C08]
Gender: Female, Male. Age: 18-64 years, 65+ years. Enrolment: 45.
Status: Ended. Start date (EU): 2024-07-24. End date (EU): 2025-07-11. End date: 2025-07-23. Decision date: 2024-04-03. Results received: Yes. Last updated: 2025-07-01.
Decision dates by country: ES: 2024-09-18, DE: 2024-06-05, CZ: 2024-09-19, PL: 2024-09-22

Condition(s): Chronic Rhinosinusitis with Nasal Polyps
Product: Veritikug (upb-101) matching solution for subcutaneous injection with no active treatment, Verekitug (UPB-101)

Primary endpoint: Change from Baseline at Week 24 in NPS
Endpoint(s): Change from Baseline at Week 24 in the NCS evaluated by the NPSD, Change from Baseline at Week 24 in opacification of sinuses measured by LMK, Change from Baseline at Week 24 in DSS evaluated by the NPSD, Proportion of participants requiring systemic corticosteroids or NP surgery, Time to nasal polyposis surgery and/or time to systemic corticosteroids for nasal polyposis up to Week 24, Change from Baseline at Week 24 in NPSD TSS, AEs, SAEs, physical examinations, clinical laboratory assessments, vital signs, and ECGs from Baseline over study duration, including the Follow-Up Period

Source: https://euclinicaltrials.eu/ctis-public/view/2023-508231-31-00